EU clinical trial 2023-503507-29-00: Prospective, multicenter, randomized, double-blind, parallel group, placebo-controlled, efficacy and safety phase 3 study of an intravenous human plasma-derived C1 esterase inhibitor (C1-INH) concentrate in participants with congenital C1-INH deficiency for the treatment and pre-procedure prevention of acute hereditary angioedema attacks
Protocol code: CONE-02
Sponsor: Octapharma Pharmazeutika Produktionsgesellschaft mbH (Pharmaceutical company). Phase: Therapeutic confirmatory (Phase III). Countries: Romania (ended), Bulgaria (ongoing, recruiting).
Therapeutic area(s): Diseases [C] - Congenital, Hereditary, and Neonatal Diseases and Abnormalities [C16]
Gender: Female, Male. Age: 0-17 years, 18-64 years, 65+ years. Enrolment: 6.
Start date (EU): 2024-04-30. Decision date: 2024-01-29. Results received: No. Last updated: 2026-07-08.
Decision dates by country: RO: 2024-01-29, BG: 2024-06-27

Condition(s): acute hereditary angioedema attacks
Product: Isotone Kochsalz-Lösung 0,9 % Braun Infusionslösung, C1-esterase inhibitor

Primary endpoint: The primary efficacy endpoint of this study is the time to the beginning of unequivocal symptom relief at the defining attack site (site of swelling or pain) in blinded participants. Participants will rate symptom relief for the defining site from the start of the first slow IMP injection every 15 minutes over 4 hours.
Endpoint(s): Percentage of participants responding to treatment, defined as beginning of unequivocal symptom relief at the defining site within 4 hours after first injection (once per participant after first QAT in the study), Time to the beginning of unequivocal symptom relief at all sites involved within 4 hours after first injection, Changes in symptom severity at the defining site by visual analog scale (VAS) rating from pre-injection over 4 hours after first injection, Time to the beginning of unequivocal symptom relief at the defining site in participants receiving open-label treatment within 4 hours after injection, Percentage of participants responding to treatment, defined as beginning of unequivocal symptom relief at the defining site within 4 hours after injection, Changes in symptom severity at the defining site by VAS rating from pre-injection over 4 hours after injection, Time to the beginning of unequivocal symptom relief at all sites involved within 4 hours after injection, Time from each open-label injection start to complete resolution of QAT attacks, Percentage of repeated attacks per participant with unequivocal symptom relief at the defining site beginning within 4 hours after injection for subsequent attacks, Time from each open-label injection start to beginning of unequivocal symptom relief at the defining site for subsequent attacks within 4 hours after injection, Time from each open-label injection start to beginning of unequivocal symptom relief at all sites involved for subsequent attacks within 4 hours after injection, Time from each open-label injection start to complete resolution of subsequent attacks, Changes in symptom severity at the defining site by VAS rating from pre-injection over 4 hours after each IMP injection for repeated attacks, Occurrence of HAE attacks within 72 hours after pre-procedure injection, Changes in QoL at the end of study compared with baseline, Number and severity of adverse events (AEs), Withdrawals due to AEs, Number and severity of AEs of special interest (AESIs), which comprise hypersensitivity, transmissible infectious agents, and AEs of the thromboembolic event (TEE) type, Changes in physical examination findings at the end of study compared with baseline, Changes in vital signs from pre- to post-injection, Changes in laboratory parameters from pre- to post-injection, Serology testing, blood nuclear antigen tests for hepatitis A virus (HAV), hepatitis B virus (HBV), hepatitis C virus (HCV), human immunodeficiency virus (HIV)-1/2, and parvovirus B19 at the end of study compared with baseline, Presence of anti-C1-INH antibodies, Number and severity of local injection site reactions AEs, Number and severity of AEs reported within 7 days after a pre-procedure injection, The PK endpoint (for participants ≥2 to <18 years of age and a subset of 30 adults) is the effect of treatment on C1-INH activity, C1-INH antigen levels, and complement component 4 (C4) antigen levels. The area under the curve (AUC) over 1 week for C1-INH activity, uncorrected and corrected for baseline, will be used as the primary PK endpoints to be matched between adult and pediatric patients

Source: https://euclinicaltrials.eu/ctis-public/view/2023-503507-29-00